EU clinical trial 2025-524617-84-00: A study to investigate the pharmacokinetics and safety of a single dose of duvakitug in healthy adult participants
Protocol code: PKM23567
Sponsor: Sanofi-Aventis Recherche & Developpement (Pharmaceutical company). Phase: Human Pharmacology (Phase I)- Other. Countries: Germany (ended).
Therapeutic area(s): Diseases [C] - Digestive System Diseases [C06]
Gender: Female, Male. Age: 18-64 years, 65+ years. Enrolment: 50.
Status: Ended. Start date (EU): 2026-04-09. End date (EU): 2026-07-07. Decision date: 2026-03-17. Results received: No. Last updated: 2026-06-17.
Decision dates by country: DE: 2026-04-22

Condition(s): Healthy Volunteers

Source: https://euclinicaltrials.eu/ctis-public/view/2025-524617-84-00